EU clinical trial 2024-519075-26-00: Neoadjuvant capecitabine, oxaliplatin, docetaxel and atezolizumab in non-metastatic, resectable gastric and GE-junction cancer - de PANDA trial
Sponsor: Het Nederlands Kanker Instituut-Antoni van Leeuwenhoek Ziekenhuis Stichting (Hospital/Clinic/Other health care facility). Phase: Therapeutic exploratory (Phase II). Countries: Netherlands (ongoing, recruiting).
Therapeutic area(s): Diseases [C] - Digestive System Diseases [C06]; Diseases [C] - Neoplasms [C04]
Gender: Female, Male. Age: 18-64 years, 65+ years. Enrolment: 21.
Status: Ongoing, recruiting. Start date (EU): 2018-02-27. Decision date: 2024-11-21. Results received: No. Last updated: 2024-11-21.

Condition(s): Primary resectable, histologically confirmed gastric or gastro-esophageal junction adenocarcinoma
Product: ELOXATIN 5 mg/ml concentraat voor oplossing voor infusie, Xeloda 150 mg film-coated tablets, Docetaxel Sandoz 10 mg/ml koncentrát na infúzny roztok, Tecentriq 1 200 mg concentrate for solution for infusion, Xeloda 500 mg film-coated tablets

Primary endpoint: Safety, measured by SAEs and treatment related complications leading to delays in systemic treatment and/or surgery
Endpoint(s): Pathological tumor regression grade and the rate of complete and near-complete response, measured using the Mandard tumor regression grading system, Effect of therapy on intratumoral T-cell infiltration, CD4/CD8 ratio and immune checkpoints upregulation in the time interval post-atezolizumab monotherapy, post combination treatment with chemotherapy and at surgery, Correlation of pre-treatment T-cell infiltration and pathological response, Radiological tumor regression, and when possible the (immune) recist criteria, will be assessed prior to cycle 4 of combination treatment, Immunogenic mutational load as determined by tumor tissue DNA WES (with peripheral blood DNA WES as a control for somatic mutation sorting) and correlated to response (only genes relating to gastric cancer and/or immune-related genes, deemed informational for this study, will be assessed), Immune suppressive pathways and IFN-y induced gene expression will be analyzed by use of RNA sequencing on pre- and post-therapy tissue. Baseline immune gene signatures will be assessed for their predictive value of response to treatment, For a limited amount of patients, changes in the tissue and peripheral blood TCR repertoire and clonality will be determined, Date of relapse, as determined by disease recurrence or disease-related death during followup after surgery. Follow-up will be performed according to the assessment table, When enough material is available, organoids cultured from both normal and tumor tissue preand post-therapy will be grown and stored

Source: https://euclinicaltrials.eu/ctis-public/view/2024-519075-26-00